EU clinical trial 2023-504731-40-01: EMPagliflozin after Aortic Valve Replacement - the EMPAVR study - a randomized clinical trial
Protocol code: 2023-504731-40-00
Sponsor: Rigshospitalet (Hospital/Clinic/Other health care facility). Phase: Therapeutic use (Phase IV). Countries: Denmark (ended).
Therapeutic area(s): Diseases [C] - Cardiovascular Diseases [C14]
Gender: Female, Male. Age: 18-64 years, 65+ years. Enrolment: 206.
Status: Ended. Start date (EU): 2024-02-07. End date (EU): 2026-05-08. Decision date: 2023-11-08. Results received: No. Last updated: 2024-07-22.

Condition(s): Aortic stenosis
Product: Glucosemonohydrate with HPMC capsule, Jardiance 10 mg film-coated tablets

Primary endpoint: Change in left ventricular mass indexed to body surface area (measured by CT) from pre aortic valve replacement (AVR) to 12-months post-AVR
Endpoint(s): Left ventricular end-systolic volume indexed to body surface are (LVESVi measured by CT), Left ventricular global longitudinal strain (LV GLS) (measured by echo), NT-proBNP change from baseline to 12 months, Composite of death and readmission for any non-planned cause

Source: https://euclinicaltrials.eu/ctis-public/view/2023-504731-40-01